EU clinical trial 2023-508534-33-00: A Phase 2/3, Open-label, Historical-controlled, Single-arm, Multicenter Study to Evaluate the Efficacy, Pharmacokinetics, Pharmacodynamics, and Safety of Ravulizumab in Children and Adolescents With Aquaporin-4 antibody Positive (AQP4-Ab [+]) Neuromyelitis Optica Spectrum Disorder (NMOSD)
Protocol code: ALXN1210-NMO-317
Sponsor: Alexion Pharmaceuticals Inc. (Pharmaceutical company). Phase: Phase II and Phase III (Integrated). Countries: France (ongoing, recruitment ended), Italy (ongoing, recruitment ended), Spain (ongoing, recruitment ended).
Therapeutic area(s): Phenomena and Processes [G] - Genetic Phenomena [G05]
Gender: Female, Male. Age: 0-17 years. Enrolment: 6.
Status: Ongoing, recruitment ended. Start date (EU): 2022-06-16. Decision date: 2024-03-27. Results received: No. Last updated: 2025-08-18.
Decision dates by country: ES: 2024-03-27, FR: 2024-04-22, IT: 2024-05-13

Condition(s): Neuromyelitis Optica Spectrum Disorder (NMOSD)
Product: Ultomiris 300 mg/3 mL concentrate for solution for infusion

Primary endpoint: - The change from baseline in the annualized relapse rate (ARR) - Time to First Adjudicated On-trial Relapse (TFR)
Endpoint(s): Efficacy: - Change from baseline in expanded disability status scale (EDSS) score - Change from baseline in Hauser Ambulation Index (HAI) - The change from baseline in visual acuity at the end of the Primary Treatment Period, Efficacy: - The change from baseline in confrontational visual fields at the end of the Primary Treatment Period - The change from baseline in color vision at the end of the Primary Treatment Period, PK/PD: - Serum ravulizumab concentrations through the end of the Primary Treatment Period - Absolute values, change from baseline, and percentage change from baseline for free serum C5 concentrations over time through the end of the Primary Treatment Period, Health-related QoL: - Change from baseline in PedsQL Scales at the end of the Primary Treatment Period, Safety: - Incidence of AEs and SAEs - Change from baseline in vital signs, physical growth (weight, height, and head circumference [participants ≤ 3 years of age only]), and laboratory parameters at scheduled visits Extension treatment period: The endpoints of the Primary Treatment Period will be evaluated during the Extension Period.

Source: https://euclinicaltrials.eu/ctis-public/view/2023-508534-33-00